EU clinical trial 2023-507443-10-00: A phase III multi-center, randomized, open-label study to evaluate the efficacy and safety of Lutathera in patients with Grade 2 and Grade 3 advanced GEP-NET (NETTER-2)
Protocol code: CAAA601A22301
Sponsor: Advanced Accelerator Applications (Pharmaceutical company). Phase: Therapeutic confirmatory (Phase III). Countries: Italy (ongoing, recruitment ended), Spain (ongoing, recruitment ended), Netherlands (ongoing, recruitment ended), Germany (ongoing, recruitment ended), France (ongoing, recruitment ended).
Therapeutic area(s): Diseases [C] - Neoplasms [C04]
Gender: Female, Male. Age: 0-17 years, 18-64 years, 65+ years. Enrolment: 90.
Status: Ongoing, recruitment ended. Start date (EU): 2019-11-04. Decision date: 2024-06-13. Results received: No. Last updated: 2026-05-12.
Decision dates by country: ES: 2024-06-13, NL: 2024-06-17, DE: 2024-06-18, IT: 2024-06-17, FR: 2024-06-27

Condition(s): Patients with somatostatin receptor positive, well-differentiated G2 and G3, advanced GEP NETs
Product: SANDOSTATIN LAR 10 mg powder and solvent for suspension for injection, LysaKare 25 g/25 g solution for infusion, SANDOSTATIN LAR 20 mg powder and solvent for suspension for injection, SANDOSTATIN LAR 30 mg powder and solvent for suspension for injection, Lutathera 370 MBq/mL solution for infusion

Primary endpoint: Progression Free Survival (PFS): Time from randomization to the first line progression (centrally assessed according to RECIST 1.1) or death due to any cause
Endpoint(s): ORR: Rate of patients with best overall response of partial response (PR) or complete response (CR) (centrally assessed according to RECIST 1.1), Time to decline (TTD) by 10 points from baseline in the following scores measured by the EORTC QLQ-C30 questionnaire: global health status, diarrhea, fatigue and pain

Source: https://euclinicaltrials.eu/ctis-public/view/2023-507443-10-00